EU clinical trial 2024-512525-83-00: A Pivotal, Multicenter, Blinded, Sham Procedure-Controlled Trial of Renal Denervation by the Peregrine System™ Kit, in Subjects with Hypertension
Protocol code: CR0002
Sponsor: Ablative Solutions Inc. (Pharmaceutical company). Phase: Therapeutic confirmatory (Phase III). Countries: Poland (ongoing, recruitment ended), France (ongoing, recruitment ended), Netherlands (ended), Austria (ended), Ireland (ended), Belgium (ended), Germany (ongoing, recruitment ended).
Therapeutic area(s): Diseases [C] - Cardiovascular Diseases [C14]
Gender: Female, Male. Age: 18-64 years, 65+ years. Enrolment: 465.
Start date (EU): 2020-01-07. Decision date: 2024-06-26. Results received: No. Last updated: 2025-12-01.
Decision dates by country: DE: 2024-06-27, BE: 2024-06-26, PL: 2024-07-15, IE: 2024-06-26, AT: 2024-08-05, NL: 2024-06-27, FR: 2024-06-27

Condition(s): Hypertension
Product: Peregrine System™ Kit

Primary endpoint: Change in mean 24-hour ambulatory SBP from baseline to 3 months post-procedure.
Endpoint(s): Change in mean office SBP from baseline to 3 months post-procedure., Change in mean office SBP from baseline to 4 weeks post-procedure., Change in mean 24-hour ambulatory SBP from baseline to 6 months post-procedure., Change in mean office SBP from baseline to 6 months post-procedure., Changes (decreases or increases) in antihypertensive medication regimen from procedure to 6 months post-procedure (titrated according to standardized formula to maintain a target office SBP of <140 mmHg and ≥90 mmHg), Change in mean daytime (07:00 to 21:59) ambulatory SBP from baseline to 3 months post-procedure., Change in mean daytime ambulatory SBP from baseline to 6 months post-procedure., Change in mean office DBP from baseline to 3 months and then 6 months post-procedure., Change in mean 24-hour ambulatory DBP from baseline to 3 months and then 6 months post-procedure., Change in mean daytime ambulatory DBP from baseline to 3 months and then 6 months post-procedure., Changes (decreases or increases) in antihypertensive medication regimen from 3 months to 6 months post-procedure (titrated according to standardized formula to maintain a target office SBP of <140 mmHg and ≥90 mmHg)., Change in mean nighttime (22:00 to 06:59) ambulatory SBP from baseline to 3 months and then 6 months post-procedure, Change in mean nighttime ambulatory DBP from baseline to 3 months and then 6 months post-procedure., ABPM Responders, defined as the proportion of subjects with a drop of ≥5 mmHg in 24-hour ambulatory SBP at 3 months compared with baseline, Office BP Responders, defined as the proportion of subjects with a drop of ≥10 mmHg in office SBP at 3 months compared with baseline, Reduction of both office SBP and DBP to normal (<140/90 mmHg) at 3, 6 and 12 months as compared to baseline., Changes (any decrease or increase) in antihypertensive medication regimen from procedure to 3 months post-procedure., Major adverse events (MAEs) through 30 days post-procedure, as adjudicated by the Clinical Events Committee (CEC)., MAEs at 3, 6, and 12 months and 2 and 3 years., Renal artery stenosis >60% diameter as indicated by imaging at 6 months., Change in eGFR from baseline to 3 months and 6 months post-procedure., Decreases in eGFR >25% from baseline to 3 months and 6 months post-procedure, Rate of AEs (serious and non-serious), peri-procedurally, at discharge, and at each of the follow-up time points., Device success (defined as the ability to insert the Peregrine Catheters into the lumen of the renal artery [target vessel], deploy the guide tubes inside the renal artery, deploy the needles through the arterial wall, deliver the intended dose of alcohol, retract the needles and the guide tubes back in the catheter, and remove the catheter from the access site without any related complications or events)., Procedure success (defined as device success with freedom from peri-procedural MAEs).

Source: https://euclinicaltrials.eu/ctis-public/view/2024-512525-83-00